EU clinical trial 2023-509832-24-00: A Multicenter, Open-Label, Randomized Study to Assess the Pharmacokinetics, Safety, and Efficacy of Two Doses of Bimekizumab in Adolescent Study Participants With Moderate to Severe Plaque Psoriasis
Protocol code: PS0020
Sponsor: UCB Biopharma (Pharmaceutical company). Phase: Therapeutic exploratory (Phase II). Countries: Poland (ended), Germany (ended).
Therapeutic area(s): Diseases [C] - Immune System Diseases [C20]
Gender: Female, Male. Age: 0-17 years. Enrolment: 38.
Status: Ended. Start date (EU): 2021-08-30. End date (EU): 2025-02-25. End date: 2025-03-13. Decision date: 2024-04-25. Results received: Yes. Last updated: 2025-02-24.
Decision dates by country: DE: 2024-04-25, PL: 2024-05-07

Condition(s): Moderate to Severe Plaque Psoriasis
Product: bimekizumab

Primary endpoint: Plasma concentration of bimekizumab at Week 0, Plasma concentration of bimekizumab at Week 1, Plasma concentration of bimekizumab at Week 4, Plasma concentration of bimekizumab at Week 8, Plasma concentration of bimekizumab at Week 12, Plasma concentration of bimekizumab at Week 16, Plasma concentration of bimekizumab at Week 20, Plasma concentration of bimekizumab at Week 36, Plasma concentration of bimekizumab at Week 40, Plasma concentration of bimekizumab at Week 64, Plasma concentration of bimekizumab at Week 88, Plasma concentration of bimekizumab at Week 112, Plasma concentration of bimekizumab at Week 124, Plasma concentration of bimekizumab at safety follow up (SFU)
Endpoint(s): Percentage of participants with treatment-emergent adverse events (TEAEs), Percentage of participants with serious TEAEs, Percentage of participants with TEAEs leading to discontinuation of investigational medicinal product (IMP), Percentage of participants with selected safety topics of interest, Change from Baseline in vital signs (systolic and diastolic blood pressure), Change from Baseline in vital signs (heart rate or pulse rate), Change from Baseline in vital signs (temperature), Change from Baseline in physical examination findings reported as TEAEs with onset occurring from day of first dose through 20 weeks after final dose of IMP, Change from Baseline in hematology parameters (platelet count), Change from Baseline in hematology parameters (mean corpuscular hemoglobin), Change from Baseline in hematology parameters (mean corpuscular volume), Change from Baseline in hematology parameters (erythrocytes), Change from Baseline in hematology parameters (hemoglobin), Change from Baseline in hematology parameters (hematocrit), Change from Baseline in hematology parameters (basophils, eosinophils, lymphocytes, monocytes, neutrophils, leukocytes), Change from Baseline in clinical chemistry parameters (calcium, potassium, sodium, blood urea nitrogen, glucose (nonfasting)), Change from Baseline in clinical chemistry parameters (alkaline phosphatase, alanine aminotransferase, aspartate aminotransferase), Change from Baseline in clinical chemistry parameters (creatinine, total and direct bilirubin), Change from Baseline in clinical chemistry parameters (total protein), Change from Baseline in height, Change from Baseline in weight, Percentage of participants with Psoriasis Area and Severity Index (PASI) 90 response at Week 16, Percentage of participants with Investigator's Global Assessment (IGA) 0/1 (Clear [0]/Almost Clear [1] with at least 2-category improvement from Baseline) response at Week 16, Percentage of participants with Psoriasis Area and Severity Index (PASI) 75 response at Week 4, Percentage of participants with anti-bimekizumab antibody (AbAb) detection prior to investigational medicinal product (IMP) administration, Percentage of participants with anti-bimekizumab antibody (AbAb) detection following investigational medicinal product (IMP) administration, Change from Baseline in Children's Dermatology Life Quality Index (CDLQI) response at Week 16

Source: https://euclinicaltrials.eu/ctis-public/view/2023-509832-24-00